EU clinical trial 2025-522531-34-00: Methotrexate PK (in combination with Novobiocin) in RA patients
Protocol code: AMP101
Sponsor: Amplio Pharma B.V. (Pharmaceutical company). Phase: Human Pharmacology (Phase I)- Other. Countries: Netherlands (temporarily halted).
Therapeutic area(s): Diseases [C] - Immune System Diseases [C20]
Gender: Female, Male. Age: 18-64 years, 65+ years. Enrolment: 16.
Status: Temporarily halted. Start date (EU): 2025-08-19. Decision date: 2025-08-19. Results received: No. Last updated: 2026-04-24.

Condition(s): Rheumatoid arthritis

Source: https://euclinicaltrials.eu/ctis-public/view/2025-522531-34-00